EU clinical trial 2023-510479-72-00: A Phase 1, Multicenter, Open-Label Study of REM-422, an MYB mRNA Degrader, in Patients With Relapsed/Refractory AML or Higher-Risk MDS
Protocol code: REM-422-102
Sponsor: Remix Therapeutics Inc. (Pharmaceutical company). Phase: Human Pharmacology (Phase I)- Other. Countries: France (ongoing, recruitment ended).
Therapeutic area(s): Diseases [C] - Neoplasms [C04]; Diseases [C] - Hemic and Lymphatic Diseases [C15]
Gender: Female, Male. Age: 18-64 years, 65+ years. Enrolment: 20.
Status: Ongoing, recruitment ended. Start date (EU): 2025-08-05. Decision date: 2024-07-08. Results received: No. Last updated: 2025-11-26.

Condition(s): Relapsed/Refractory AML or Higher-Risk MDS

Source: https://euclinicaltrials.eu/ctis-public/view/2023-510479-72-00